EU clinical trial 2023-504232-18-00: A Phase I, Single-Centre, Double-Blind, Randomized, Placebo-Controlled Clinical Trial To Determine Urinary Xylose Cut-Off Point For The Diagnosis Of Hypolactasia, After A Single Dose Of Gaxilose in Children Between 5 – 11 Years Of Age.
Protocol code: VPH-GXL-2022-511
Sponsor: Venter Pharma S.L. (Pharmaceutical company). Phase: Human Pharmacology (Phase I)- Other. Countries: Spain (ended).
Therapeutic area(s): Diseases [C] - Digestive System Diseases [C06]
Gender: Female, Male. Age: 0-17 years. Enrolment: 18.
Status: Ended. Start date (EU): 2023-06-22. End date (EU): 2023-06-30. Decision date: 2023-06-16. Results received: Yes. Last updated: 2023-06-16.

Condition(s): Hypolactasia
Product: LacTEST 0,45 g polvo para solución oral.

Primary endpoint: PK analysis for urinary xylose excretion will be based on the following parameters: maximum urinary excretion rate detected at 0-3, 3-4 and 4-5h; its mean time during the corresponding interval (Tmax) and total xylose excreted (Ae0-5). All urine samples will be analyzed at a laboratory located in Hospital Universitario de Getafe
Endpoint(s): The incidence of adverse events (AEs), as well as relevant and abnormal changes from baseline in laboratory test results, and changes to vital signs in the treatment arm compared to the control arm.

Source: https://euclinicaltrials.eu/ctis-public/view/2023-504232-18-00